EU clinical trial 2023-503256-27-00: Open-label single-arm, multicenter clinical trial to evaluate patient acceptability of a new CREON formulation of Pancreas Powder gastro-resistant pellets in patients with cystic fibrosis suffering from pancreatic exocrine insufficiency.
Protocol code: PANC-GRP-3001
Sponsor: MEDA Pharma GmbH & Co. KG (Pharmaceutical company). Phase: Human Pharmacology (Phase I)- Other. Countries: Germany (ended).
Therapeutic area(s): Diseases [C] - Respiratory Tract Diseases [C08]
Gender: Female, Male. Age: 18-64 years, 65+ years. Enrolment: 60.
Status: Ended. Start date (EU): 2024-04-18. End date (EU): 2024-12-19. End date: 2024-12-20. Decision date: 2024-02-19. Results received: Yes. Last updated: 2024-09-12.

Condition(s): patients with cystic fibrosis suffering from pancreatic exocrine insufficiency
Product: Creon 25.000, harde maagsapresistente capsules 25.000 eenheden, Creon 50000 Ph.Eur. lipase units, Creon 25000 Ph.Eur. lipase units, Creon 10000 Ph.Eur. lipase units, Creon 75000 Ph.Eur. lipase units, Creon® 10000 Capsules

Primary endpoint: Acceptability of study treatment assessed at Visit 3 (Day 8): • Opening the container • Emptying the dose from container • Taste • Tactile sensation • Color • Time spent taking the dose • General convenience taking the dose • Ease of swallowing • Preparation of final dose to be ingested • Number of dose units to be ingested • Experience of aftertaste after ingestion of treatment • Feeling of fulness after ingestion of the treatment
Endpoint(s): Lipase dose used per main meal, snack, and over the day, used number of capsules/new formulation., Closing switch questions: o Would you switch your current treatment to the new formulation? o If you would switch to a combination of capsules and new formulation: Under which of the following circumstances, would you use the new formulation? To what extent would you use the new formulation:, Clinical symptoms o Stool frequency per day o Stool consistency (hard, formed, loose) o Abdominal pain on average (none, mild, moderate, severe) o Flatulence on average (none, mild, moderate, severe), Safety and tolerability o Incidence of Adverse events o Incidence of stomatitis/ oral mucosal irritation (investigator) o Inspection of oral cavity /Local tolerability assessment: • Inspection of oral cavity (stomatitis/ oral mucosal irritation, bleeding, ulcera) (by investigator) • Question regarding pain in mouth (subject)

Source: https://euclinicaltrials.eu/ctis-public/view/2023-503256-27-00